EU clinical trial 2024-513601-31-00: Phase 2 study of the infusion of differentiated autologous T-cells from peripheral blood, expanded and transduced with a lentivirus to express a chimeric antigen receptor with anti-CD19 specificity (A3B1) conjugated with the co-stimulatory regions 4-1BB and CD3z (ARI-0001 cells) in patients with CD19+ acute lymphoid leukemia resistant or refractory to therapy
Protocol code: CART19-BE-02
Sponsor: Fundacio De Recerca Clinic Barcelona-Institut D’Investigacions Biomediques August Pi I Sunyer (Laboratory/Research/Testing facility). Phase: Therapeutic exploratory (Phase II). Countries: Spain (ongoing, recruiting).
Therapeutic area(s): Diseases [C] - Neoplasms [C04]
Gender: Female, Male. Age: 18-64 years, 65+ years. Enrolment: 32.
Status: Ongoing, recruiting. Start date (EU): 2024-05-13. Decision date: 2024-05-13. Results received: No. Last updated: 2024-10-24.

Condition(s): Acute lymphoid leukemia
Product: Varnimcabtagene autoleucel, BENDAMUSTINE, FLUDARABINE, DEXCHLORPHENIRAMINE, CYCLOPHOSPHAMIDE, PARACETAMOL, TOCILIZUMAB, ALLOPURINOL

Primary endpoint: Response rate with measurable residual disease negative by multiparametric flow cytometry 28 days after infusion of ARI-0001 cells.
Endpoint(s): Duration of response, Best response during the first 3 months of follow-up after administration of the first fractioned dose of ARI-0001, Progression-free survival at 6 months and 1 year of the infusion and after the signature of informed consent., Overall Survival (OS) at 1 year of the infusion and after the informed consent form signature, Assessment of ARI-0001 cell toxicity considering special interest in the following adverse events: CRS (cytokine release syndrome), encephalopathy associated with CARs (ICANS) and cerebral edema. Mortality related to study procedures and adverse events grade 3-4 will be evaluated at month 3 and year 1. Intensity will be assessed using CTCAE version 5.0 scale. To evaluate CRS and neurotoxicity ASTCT criteria will be used., In vivo survival of ARI-0001 cells in peripheral blood, bone narrow and cerebrospinal fluid, to be determined by flow cytometry and quantitative transgene PCR with monthly frequency in the first 6 months and thereafter quarterly up to 2 years of infusion

Source: https://euclinicaltrials.eu/ctis-public/view/2024-513601-31-00